EU clinical trial 2024-512101-60-00: A study to learn how vamorolone affects the body, how safe it is and how it moves into, through and out of the body in healthy male participants
Protocol code: SNT-I-VAM-026
Sponsor: Santhera Pharmaceuticals (Schweiz) AG (Pharmaceutical company). Phase: Human Pharmacology (Phase I)- Other. Countries: Germany (ended).
Therapeutic area(s): Diseases [C] - Musculoskeletal Diseases [C05]
Gender: Male. Age: 18-64 years. Enrolment: 30.
Status: Ended. Start date (EU): 2024-06-05. End date (EU): 2024-07-06. Decision date: 2024-05-06. Results received: No. Last updated: 2024-05-06.

Condition(s): Phase I study in healthy male volunteers. Intended indication: Duchenne muscular dystrophy and Becker muscular dystrophy

Source: https://euclinicaltrials.eu/ctis-public/view/2024-512101-60-00